EU clinical trial 2024-510941-32-00: DAPA-ICU Trial - Dapagliflozin for cardio-renal protection after ICU discharge. A prospective, randomized, double blinded, multicenter study
Protocol code: APHP220826
Sponsor: Assistance Publique Hopitaux De Paris (Hospital/Clinic/Other health care facility). Phase: Therapeutic confirmatory (Phase III). Countries: France (ongoing, recruiting).
Therapeutic area(s): Diseases [C] - Cardiovascular Diseases [C14]
Gender: Female, Male. Age: 18-64 years, 65+ years. Enrolment: 600.
Status: Ongoing, recruiting. Start date (EU): 2025-12-02. Decision date: 2025-05-07. Results received: No. Last updated: 2026-08-07.

Condition(s): Adult patients discharged alive from ICU with a decreased eGFR, and/or an AKI during ICU stay and/or an elevated NT-proBNP at discharge.
Product: Placebo du FORXIGA 10 mg, Forxiga 10 mg film-coated tablets

Primary endpoint: A composite outcome composed of: • all-cause mortality, at one year after ICU discharge • and/or unscheduled hospital hospitalization for heart failure, at one year after ICU discharge • and/or a decrease of eGFR by more than 50% from baseline (ICU discharge) and/or end stage kidney disease defined as an eGFR<15ml/min/1.73m² and/or initiation of renal replacement therapy and/or kidney transplantation at one year after ICU discharge
Endpoint(s): Unscheduled hospital hospitalization for cardiovascular events (acute heart failure, stroke, acute coronary syndrome) during the year following ICU discharge, Occurrence of severe chronic kidney disease one year after ICU discharge defined as eGFR <30 ml/min/1.73m2, Decrease of estimated glomerular filtration rate of more than 50% from baseline one year after ICU discharge, New episode of acute kidney injury (according to the KDIGO criteria) requiring hospitalization in the year following ICU discharge, Occurrence of end stage kidney disease defined (eGFR<15ml/min/1.73m2) and/or initiation of renal replacement therapy and/or kidney transplantation one year after ICU discharge, Variation of NT-proBNP or BNP, eGFR between 12 months (end of treatment) and 12 months + 6 weeks (end of study), Occurrence of cardiovascular events during of the treatment duration, Occurrence of renal events during of the treatment duration, Occurrence of global outcome events during of the treatment duration, Safety endpoints are evaluated during the year after ICU discharge: Urinary tract infection / Necrotizing fasciitis / Symptomatic ketoacidosis (Arterial pH <7.3 and high blood Ketone levels and Anion gap <10 mEq/L and Drowsy, stupor or coma) / Major hypoglycaemia (glycemia < 3mmol/L) / Death of any cause

Source: https://euclinicaltrials.eu/ctis-public/view/2024-510941-32-00